EU clinical trial 2023-508253-98-00: A Phase III, Randomized, Double-blind Trial Comparing Trastuzumab Plus Chemotherapy and Pembrolizumab With Trastuzumab Plus Chemotherapy and Placebo as First-line Treatment in Participants With HER2 Positive Advanced Gastric or Gastroesophageal Junction Adenocarcinoma (KEYNOTE 811)
Protocol code: MK-3475-811
Sponsor: Merck Sharp & Dohme LLC (Pharmaceutical company). Phase: Therapeutic confirmatory (Phase III). Countries: Ireland (ended), France (ended), Spain (ended), Germany (ended), Poland (ended), Italy (ended).
Therapeutic area(s): Diseases [C] - Neoplasms [C04]
Gender: Female, Male. Age: 18-64 years, 65+ years. Enrolment: 167.
Status: Ended. Start date (EU): 2018-10-05. End date (EU): 2025-11-11. End date: 2025-11-12. Decision date: 2023-12-14. Results received: No. Last updated: 2025-09-12.
Decision dates by country: FR: 2024-01-05, PL: 2024-04-22, DE: 2023-12-22, ES: 2023-12-19, IT: 2024-01-29, IE: 2023-12-14

Condition(s): Gastric or gastroesophageal junction (GEJ) adenocarcinoma
Product: FLUOROURACIL, CISPLATIN, CAPECITABINE, CISPLATIN, TRASTUZUMAB, Placebo for Pembrolizumab, OXALIPLATIN, KEYTRUDA 25 mg/mL concentrate for solution for infusion, CAPECITABINE, TRASTUZUMAB

Primary endpoint: Progression-Free Survival (PFS) per RECIST 1.1 assessed by Blinded Independent Central Review (BICR), Overall Survival (OS)
Endpoint(s): Objective Response Rate (ORR) per RECIST 1.1 assessed by BICR, Duration of Response (DOR) per RECIST 1.1 assessed by BICR, Number of Participants Who Experience an Adverse Event (AE), Number of Participants Who Discontinue Study Treatment Due to an AE

Source: https://euclinicaltrials.eu/ctis-public/view/2023-508253-98-00